EU clinical trial 2023-504323-25-01: A Randomized, Multicenter, Placebo-controlled, Phase 3 study to Evaluate the Efficacy and Safety of HER2/neu Peptide GLSI-100 (GP2 + GM-CSF) in HER2/neu Positive Subjects with Residual Disease or High-Risk PCR after both Neoadjuvant and Postoperative Adjuvant Trastuzumab-based Therapy (FLAMINGO-01)
Protocol code: GLSI-21-01
Sponsor: Greenwich LifeSciences Inc. (Pharmaceutical company). Phase: Therapeutic confirmatory (Phase III). Countries: France (ongoing, recruiting), Italy (ongoing, recruiting), Germany (ongoing, recruiting), Spain (ongoing, recruiting), Poland (ongoing, recruiting), Ireland (ongoing, recruiting), Romania (ongoing, recruiting), Portugal (ongoing, recruiting), Belgium (ongoing, recruiting), Austria (authorised, recruitment pending).
Therapeutic area(s): Diseases [C] - Neoplasms [C04]
Gender: Female, Male. Age: 18-64 years, 65+ years. Enrolment: 435.
Start date (EU): 2024-03-19. Decision date: 2024-02-19. Results received: No. Last updated: 2026-08-06.
Decision dates by country: PL: 2024-02-23, DE: 2024-02-21, RO: 2025-06-11, BE: 2025-07-25, IE: 2025-06-03, AT: 2025-09-29, ES: 2024-02-19, PT: 2025-09-09, IT: 2024-02-21, FR: 2024-02-20

Condition(s): breast cancer
Product: Leukine, Commercially available 0,9 % Sterile Saline solution with marketing authorization will be utilized as the placebo.

Primary endpoint: IBCFS is defined as the time from randomization (or first dose of study medication if in the non-randomized arm) until the date of ipsilateral invasive breast cancer recurrence, ipsilateral local-regional invasive breast cancer recurrence, distant recurrence, contralateral invasive breast cancer, or any cause mortality.
Endpoint(s): IDFS is defined as the time from randomization (or first dose of study medication if in the non-randomized arm) until the date of ipsilateral invasive breast cancer recurrence, ipsilateral local-regional invasive breast cancer recurrence, distant recurrence, contralateral invasive breast cancer, second primary non-breast invasive cancer, or any cause mortality., The overall survival (OS) in the study population as defined as the time from randomization (or first dose of study medication if in the non-randomized arm) until death from any cause., Quality of life as assessed by QLQ-C30 and FACT-GP5., The frequency of adverse events (AEs) and serious adverse events (SAEs) characterized by type, severity (as defined by the NIH CTCAE, version 5.0), seriousness, duration, and relationship to study treatment., Exploratory Endpoints: • Immune response will be measured by Delayed-Type Hypersensitivity (DTH) tests and immunologic assays. • Safety, efficacy, and immune response as defined above in non-HLA-A*02 breast cancer subjects

Source: https://euclinicaltrials.eu/ctis-public/view/2023-504323-25-01